EU clinical trial 2024-513659-34-00: ALYCANTE - Phase 2, Open-Label Study Evaluating Axi-Cel as a 2nd line therapy in patients with Relapsed/Refractory aggressive B-NHL who are ineligible to Autologous Stem Cell Transplantation
Protocol code: ALYCANTE
Sponsor: LYSARC (Laboratory/Research/Testing facility). Phase: Phase I and Phase II (Integrated)- Other. Countries: France (ongoing, recruitment ended).
Therapeutic area(s): Diseases [C] - Hemic and Lymphatic Diseases [C15]
Gender: Female, Male. Age: 18-64 years, 65+ years. Enrolment: 42.
Status: Ongoing, recruitment ended. Start date (EU): 2021-02-12. Decision date: 2024-05-06. Results received: No. Last updated: 2025-10-08.

Condition(s): Relapsed/Refractory aggressive B-NHL
Product: FLUDARABINE PHOSPHATE, CYCLOPHOSPHAMIDE, AXICABTAGENE CILOLEUCEL

Primary endpoint: CMR at 3 months based on investigator disease assessment according to PET-scan using the Lugano Response Criteria
Endpoint(s): CMR at 3 months from Axi-cel infusion (without additional anticancer therapy) determined by central imaging review (using the Lugano Response Criteria), Event-free survival (EFS) at 3, 6 and 12 months from leukapheresis based on investigator disease assessment. EFS is defined as the time between leukapheresis and: o any event preventing Axi-cel infusion if Axi-cel is never infused, or o death, disease progression, or instauration of a new lymphoma therapy for lymphoma progression after Axi-cel infusion., EFS at 3, 6 and 12 months from leukapheresis based on central imaging review. EFS is defined as the time between leukapheresis and: o any event preventing Axi-cel infusion if Axi-cel is never infused, or o death, disease progression, or instauration of a new lymphoma therapy for lymphoma progression after Axi-cel infusion., Modified EFS (mEFS) at 6 and 12 months from leukapheresis based on investigator assessment and central imaging review. mEFS is defined as the time between leukapheresis and: o any event preventing Axi-cel infusion if Axi-cel is never infused, or o death, disease progression, or instauration of a new lymphoma therapy for lymphoma progression after Axi-cel infusion or failure to achieve a CMR at 6 and 12 months post-CAR infusion., Best objective response (complete and partial metabolic response), Duration of response (DOR), Progression-free survival (PFS) from Axi-cel infusion, Overall survival (OS) from leukaphaeresis and Axi-cel infusion, DOR, PFS, OS at 2 years and 3 years, Safety of Axi-cel, Health-related Quality of life (EORTC QLQ-C30, EQ-5D-5L and QLQ-NHLHG29)

Source: https://euclinicaltrials.eu/ctis-public/view/2024-513659-34-00